EU clinical trial 2024-519502-12-00: Bioavailability, Biopotency and Food effect study of SCD0503 compared to subcutaneous regular human insulin
Protocol code: SCD-4E001
Sponsor: Samchundang Pharm. Co. Ltd. (Pharmaceutical company). Phase: Human Pharmacology (Phase I)- First administration to humans. Countries: Germany (ongoing, recruiting).
Therapeutic area(s): Diseases [C] - Nutritional and Metabolic Diseases [C18]
Gender: Male. Age: 18-64 years. Enrolment: 16.
Status: Ongoing, recruiting. Start date (EU): 2026-05-29. Decision date: 2026-05-28. Results received: No. Last updated: 2026-05-28.

Condition(s): Type 1 diabetes

Source: https://euclinicaltrials.eu/ctis-public/view/2024-519502-12-00